EU clinical trial 2022-501063-41-00: A Phase III, Multicentre, Randomised, Double-blind, Chronic-dosing, Parallel-group, Placebo-controlled Extension Study to Evaluate the Long-term Efficacy and Safety of Tozorakimab in Participants with Chronic Obstructive Pulmonary Disease (COPD) with a History of Exacerbations (PROSPERO)
Protocol code: D9180C00008
Sponsor: Astrazeneca AB (Pharmaceutical company). Phase: Therapeutic confirmatory (Phase III). Countries: Sweden (ended), Romania (ended), Spain (ended), Italy (ended), Germany (ended), Poland (ended), Finland (ended), Czechia (ended), Hungary (ended), Bulgaria (ended), Denmark (ended), Belgium (ended), Netherlands (ended), Norway (ended), France (ended), Greece (ended), Portugal (ended).
Therapeutic area(s): Diseases [C] - Respiratory Tract Diseases [C08]
Gender: Female, Male. Age: 18-64 years, 65+ years. Enrolment: 802.
Status: Ended. Start date (EU): 2023-04-20. End date (EU): 2026-05-19. End date: 2026-05-27. Decision date: 2023-03-27. Results received: No. Last updated: 2026-03-24.
Decision dates by country: DE: 2023-04-03, PL: 2023-04-03, GR: 2023-07-17, RO: 2023-03-30, BG: 2023-04-03, BE: 2023-03-27, CZ: 2023-03-31, DK: 2023-03-27, FI: 2023-03-31, HU: 2023-03-30, IT: 2023-03-30, ES: 2023-04-03, NL: 2023-03-28, NO: 2023-03-30, FR: 2023-07-20, PT: 2023-07-13, SE: 2023-05-03

Condition(s): Chronic Obstructive Pulmonary Disease (COPD)
Product: Tozorakimab - Placebo, Tozorakimab

Primary endpoint: Annualized rate of severe COPD exacerbation for Tozorakimab versus placebo in former smokers.
Endpoint(s): Annualised rate of severe COPD exacerbations in former or current smokers., Time to first severe COPD exacerbations in former smokers., Time to first severe COPD exacerbations in former or current smokers., Time to First Moderate to Severe COPD Exacerbation., Annualised Rate of Moderate-to-Severe COPD Exacerbations., Time to Death (All-cause mortality)., Pharmacokinetics, Immunogenicity, To assess the long-term safety and tolerability of tozorakimab, Annualised rate of COPD exacerbations requiring hospitalisation and/or ER/ED visits in former smokers., Annualised rate of COPD exacerbations requiring hospitalisation and/or ER/ED visits in former or current smokers.

Source: https://euclinicaltrials.eu/ctis-public/view/2022-501063-41-00